EU clinical trial 2024-516233-12-00: Sotorasib combined with first-line chemotherapy for advanced pancreatic adenocarcinoma with KRAS p.G12C mutation
Protocol code: TTD-24-01 (PANSOTO)
Sponsor: Asociacion Grupo Tratamiento De Tumores Digestivos (Patient organisation/association). Phase: Human Pharmacology (Phase I)- Other. Countries: France (authorised, recruitment pending), Spain (ongoing, recruiting).
Therapeutic area(s): Diseases [C] - Digestive System Diseases [C06]
Gender: Female, Male. Age: 18-64 years, 65+ years. Enrolment: 15.
Start date (EU): 2025-08-08. Decision date: 2025-04-29. Results received: No. Last updated: 2025-12-26.
Decision dates by country: FR: 2025-04-29, ES: 2025-05-06

Condition(s): Advanced pancreatic adenocarcinoma
Product: LUMYKRAS 240 mg film-coated tablets, PACLITAXEL, OXALIPLATIN, IRINOTECAN, FLUOROURACIL, GEMCITABINE, CALCIUM FOLINATE

Primary endpoint: Incidence of treatment-emergent adverse events (TEAEs) and related TEAEs (TRAEs) according to CTCAE V5.0 and of clinically relevant changes in laboratory data, vital signs, and physical examination
Endpoint(s): Overall response (OR), disease control (DC), duration of response (DOR), and duration of stable disease, measured by CT or MRI and assessed per RECIST 1.1 criteria, Progression-free survival (PFS), measured by CT or MRI and assessed per RECIST 1.1 criteria, Overall survival (OS), Pharmacokinetic parameters of products including, but not limited to, maximum plasma concentration (Cmax) and trough concentrations (Ctrough).

Source: https://euclinicaltrials.eu/ctis-public/view/2024-516233-12-00